EU clinical trial 2024-516018-39-00: SEM-CORTICO.Severe erythema multiform: A randomized controlled trial com-paring a short systemic corticosteroids regimen to placebo in the acute established phase.
Protocol code: APHP200073
Sponsor: Assistance Publique Hopitaux De Paris (Hospital/Clinic/Other health care facility). Phase: Therapeutic confirmatory (Phase III). Countries: France (authorised, recruitment pending).
Therapeutic area(s): Diseases [C] - Skin and Connective Tissue Diseases [C17]
Gender: Female, Male. Age: 0-17 years, 18-64 years, 65+ years. Enrolment: 96.
Status: Authorised, recruitment pending. Decision date: 2024-09-04. Results received: No. Last updated: 2026-05-26.

Condition(s): Erythema multiforme (EM) in its severe form managed at the hospital
Product: PREDNISONE ARROW 20 mg, comprimé sécable, METHYLPREDNISOLONE, Glucose 5%, Placebo de prednisone ARW 20 mg - Hydrogénophosphate de calcium dihydraté (94%) Stéarate de magnésium (1%); Amidon de maïs Lycatab C (5%), NaCl 0.9%

Primary endpoint: The time to success defined by controlled pain (Nu-meric Rating Scale (NR, range 0-10) score <4 and sustained no need for any level III analgesics, during 48 hours), resumption of chopped or solid food intake and no need for rescue therapy (IV methylprednisolone at 1mg/kg/day with discontin-uation of the current treatment in both arms).
Endpoint(s): Time to clear or almost clear healing of all sites (“clear” is defined as no erosion or skin ulceration and absence of new lesions and “almost clear” is defined as “presence of 1, or 2 maximum, micro erosions / punctiform millimetric erosions, and absence of new lesions”). Healing will be evaluated by the clinician daily., Time to fever resolution (fever resolution defined as absence of fever (temperature ≤ 37,8° C) for at least 24h), Length of hospital stay, Number of days of consumption of level III analgesics at least once in the day, Pain will be assessed three times a day during hospitalization and once a day (worst score of the day) after the hospitalization until achievement of the primary endpoint, Chopped or solid food intake resumption evaluated with daily food intake evaluation (cf. Appendix 4 of Protocol), Rate of patients in the two groups with need for a rescue therapy (IV methylprednisolone at 1mg/kg/day with discontinuation of the current treatment in both arms), Taux de séquelles (cutanées et muqueuses (séquelles oculaires, ORL, oesophagiennes, pulmonaires et génitales) évaluées cliniquement à 3 mois (M3) et 6 mois (M6), Rate of adverse events during the treatment and follow-up, Evaluation of the quality of life with the use of Patient Global Impression of Change (PGIC), scale on 7 points, at the end of hospitalization, D7, D15, M1 and in case of relapse

Source: https://euclinicaltrials.eu/ctis-public/view/2024-516018-39-00